EU clinical trial 2023-508982-34-00: MK-7480 Multiple Ascending Dose Study in Healthy Participants
Protocol code: MK-7480-002
Sponsor: Merck Sharp & Dohme LLC (Pharmaceutical company). Phase: Human Pharmacology (Phase I)- Other. Countries: Belgium (ended).
Therapeutic area(s): Diseases [C] - Digestive System Diseases [C06]
Gender: Male. Age: 18-64 years. Enrolment: 44.
Status: Ended. Start date (EU): 2024-02-09. End date (EU): 2024-06-26. End date: 2024-06-27. Decision date: 2024-02-02. Results received: No. Last updated: 2024-03-21.
Decision dates by country: BE: 2024-03-21

Condition(s): Non-alcoholic steatohepatitis

Source: https://euclinicaltrials.eu/ctis-public/view/2023-508982-34-00